EU clinical trial 2024-515055-38-00: Prospective Randomized Evaluation of Emerging Novel Treatments for Infection prophylaxis in Total Joint Replacement (PREVENT-iT)
Protocol code: PiT-023
Sponsor: Hamilton Health Sciences Corporation (Hospital/Clinic/Other health care facility). Phase: Therapeutic confirmatory (Phase III). Countries: Spain (ongoing, recruiting).
Therapeutic area(s): Diseases [C] - Bacterial Infections and Mycoses [C01]; Diseases [C] - Musculoskeletal Diseases [C05]
Gender: Female, Male. Age: 18-64 years, 65+ years. Enrolment: 325.
Status: Ongoing, recruiting. Start date (EU): 2025-02-13. Decision date: 2024-10-08. Results received: No. Last updated: 2026-04-27.

Condition(s): Adult patients undergoing TJR surgery.
Product: VANCOMYCIN, CHLORHEXIDINE, POVIDONE

Primary endpoint: The primary outcome is infection that requires reoperation within 12 months of TJR.

Source: https://euclinicaltrials.eu/ctis-public/view/2024-515055-38-00